EU clinical trial 2025-523817-27-00: KF2025#1 trial: Ketamine, cannabidiol and cobicistat interaction study
Sponsor: HUS-yhtymae (Hospital/Clinic/Other health care facility). Phase: Human Pharmacology (Phase I)- Bioequivalence Study. Countries: Finland (ended).
Therapeutic area(s): Not possible to specify
Gender: Female, Male. Age: 18-64 years. Enrolment: 12.
Status: Ended. Start date (EU): 2026-03-05. End date (EU): 2026-06-02. Decision date: 2026-02-16. Results received: No. Last updated: 2026-02-23.
Decision dates by country: FI: 2026-02-23

Condition(s): Terveet vapaaehtoiset tutkittavat

Source: https://euclinicaltrials.eu/ctis-public/view/2025-523817-27-00